EU clinical trial 2024-515896-37-00: Optimalization Of The Time And Dosage Of Trametinib In BRAF Negative Juvenile Patients With Refractory Histiocytosis Or After Failure Of Vemurafenib Treatment.
Protocol code: TRAM
Sponsor: Instytut Matki I Dziecka (Hospital/Clinic/Other health care facility). Phase: Therapeutic exploratory (Phase II). Countries: Poland (ongoing, recruitment ended).
Therapeutic area(s): Diseases [C] - Neoplasms [C04]
Gender: Female, Male. Age: 0-17 years. Enrolment: 12.
Status: Ongoing, recruitment ended. Start date (EU): 2021-04-20. Decision date: 2024-08-26. Results received: No. Last updated: 2025-10-30.

Condition(s): histiocytic cell proliferation
Product: TRAMETINIB DIMETHYL SULFOXIDE

Primary endpoint: EFS – (event-free survival)., Assessment of the safety of trametinib treatment by AE analysis including adverse events of a special interest., Assessment of the safety of trametinib treatment by vital signs, laboratory tests, echocardiography and ECG findings analysis., To determine dose of the investigated substance in patient below 18 y.o. that provides exposition to the drug similar to exposition recommended in adults.
Endpoint(s): PFS (Progression-Free Survival), OS (Overall Survival), ORR (Overall Response Rate), Reactivation rate after 2 years

Source: https://euclinicaltrials.eu/ctis-public/view/2024-515896-37-00